EU clinical trial 2024-514981-37-00: A randomized, double blind, placebo-controlled, dose response, phase II, multicentre trial to evaluate the efficacy and safety of oral AP1189 administered at the doses of 40, 70, or 100 mg for 12 weeks in combination with methotrexate, in DMARD-naïve participants with early rheumatoid arthritis and active inflammation.
Protocol code: CS008
Sponsor: Synact Pharma ApS (Pharmaceutical company). Phase: Therapeutic exploratory (Phase II). Countries: Bulgaria (ended), Czechia (ended), Poland (ended), Romania (ended), Denmark (ended).
Therapeutic area(s): Diseases [C] - Immune System Diseases [C20]
Gender: Female, Male. Age: 18-64 years, 65+ years. Enrolment: 172.
Status: Ended. Start date (EU): 2024-12-05. End date (EU): 2026-05-11. End date: 2026-05-12. Decision date: 2024-11-18. Results received: No. Last updated: 2026-03-27.
Decision dates by country: BG: 2024-11-22, CZ: 2024-11-20, RO: 2024-11-21, DK: 2024-11-18, PL: 2025-01-27

Condition(s): Rheumatoid Arthritis
Product: AP1189 Tablet, AP1189 Tablet, AP1189 Tablet, Matching Placebo (tablets), Methotrexat-Ebewe, 2,5 mg, tabletki

Primary endpoint: Change from Baseline in DAS28(CRP) after 12 weeks of combined treatment with AP1189/Placebo and MTX
Endpoint(s): ACR20 responder rate at Week 12, ACR50 responder rate at Week 12, ACR70 responder rate at Week 12, Change from baseline of the 7 individual components of the ACR criteria (tender/painful joint count, swollen joint count, Patient’s assessment of arthritis pain, Patient Global Assessment of arthritis (PtGA), Physician Global Assessment of arthritis (PhGA), HAQ-DI, serum CRP) at each time point, Change from baseline in DAS28 at each time point, Proportion of participants with Low, Moderate, or High Disease Activity based on DAS28 at each time point, Proportion of participants fulfilling DAS28 remission criteria at each time point (DAS28<2.6), Proportion of participants achieving a Good EULAR response (a DAS28 score≤3.2 at the considered visit, together with an improvement from baseline in DAS28>1.2) at each time point, Change from baseline in SDAI and CDAI at each time point, Proportion of participants with Low, Moderate, or High Disease Activity based on SDAI and CDAI at each time point, Proportion of participants fulfilling the ACR/EULAR remission criteria at each time point, Proportion of participants achieving HAQ DI MCID (>0.22 reduction in HAQ DI from baseline)

Source: https://euclinicaltrials.eu/ctis-public/view/2024-514981-37-00